EU clinical trial 2025-521521-33-00: A seamless Phase 2/3 randomized, open-label study to investigate efficacy and safety of frexalimab versus tacrolimus in adult kidney transplant recipients
Protocol code: EFC18554
Sponsor: Sanofi-Aventis Recherche & Developpement (Pharmaceutical company). Phase: Phase II and Phase III (Integrated). Countries: Germany (authorised, recruitment pending), Hungary (authorised, recruitment pending), Italy (authorised, recruitment pending), Belgium (authorised, recruitment pending), Czechia (ongoing, recruiting), Finland (authorised, recruitment pending), Spain (ongoing, recruiting), Austria (authorised, recruitment pending), Sweden (authorised, recruitment pending), France (authorised, recruitment pending), Denmark (authorised, recruitment pending), Netherlands (authorised, recruitment pending).
Therapeutic area(s): Diseases [C] - Immune System Diseases [C20]
Gender: Female, Male. Age: 18-64 years, 65+ years. Enrolment: 269.
Start date (EU): 2026-04-02. Decision date: 2026-02-23. Results received: No. Last updated: 2026-06-22.
Decision dates by country: SE: 2026-02-23, BE: 2026-02-23, NL: 2026-02-23, CZ: 2026-02-24, HU: 2026-02-26, AT: 2026-03-01, DK: 2026-02-23, FR: 2026-02-23, FI: 2026-02-27, DE: 2026-02-26, IT: 2026-02-24, ES: 2026-03-02

Condition(s): Kidney transplant rejection
Product: Prograf 1 mg Hartkapseln, Prograft 0,5 mg capsules, hard, Prograf 5 mg Hartkapseln, Prograft 5 mg capsules, hard, Frexalimab, Prograft 1 mg capsules, hard, Prograf 0,5 mg Hartkapseln

Primary endpoint: Composite efficacy failure rate (BPAR, graft loss, and death) by 1 year post kidney transplantation
Endpoint(s): eGFR at 1 year post kidney transplantation, eGFR at 6 months, 2 years, 3 years, 4 years, and 5 years post kidney transplantation, Change of eGFR from Month 3 over time up to 5 years post kidney transplantation, Participant status of eGFR >60 mL/min/1.73 m2 at 1, 2, 3, and 5 years post kidney transplantation, Participant status of eGFR <60 mL/min/1.73 m² at Month 12 or with a >10 mL/min/1.73 m² decrease in eGFR from Month 3 to 12, Proteinuria at 6 months, 1 year, 2 years, 3 years, 4 years, and 5 years post kidney transplantation, iBox score at 1 year post kidney transplantation, Composite of participant and graft survival at 5 years post kidney transplantation, Composite of participant and graft survival over time and at 6 months, 1 year, 2 years, 3 years, and 4 years post kidney transplantation, Death-censored graft survival over time and at 6 months, 1 year, 2 years, 3 years, 4 years, and 5 years post kidney transplantation (including the causes of graft loss), Participant survival over time and at 6 months, 1 year, 2 years, 3 years, 4 years, and 5 years post kidney transplantation (including the causes of death), Incidence of BPAR (yearly and cumulative) up to 5 years post kidney transplantation, Time to first BPAR, Incidence of graft rejection at 6 months, 1 year, 2 years, 3 years, 4 years, and 5 years post kidney transplantation, Incidence of rejection episodes with clinical resolution up to 5 years post kidney transplantation, Composite efficacy failure rate (BPAR, graft loss, and death) by 6 months post kidney transplantation, Incidence of de novo donor-specific antibodies at 1 year post kidney transplantation, Incidence of de novo donor-specific antibodies at 5 years post kidney transplantation, Participants with AEs, SAEs, AEs leading to permanent study intervention discontinuation, AESIs, and PCSAs in laboratory tests, ECG, and vital signs during the study period, Participants with medical device AEs, ADEs, medical device SAEs, SADEs, and device deficiencies during the study period, Side effects of immunosuppressive therapy evaluated by MTSOSD-59R score at Months 1, 2, 3, 4, 5, 6 and then every 6 months until the end of the study, Frexalimab plasma concentration over time, Incidence, titer, and persistence of ADA, Incidence of new-onset diabetes post kidney transplantation, Incidence and prevalence of hypertension, anti-hypertensive regimen, and systolic and diastolic blood pressure, Incidence and prevalence of dyslipidemia, lipid-lowering regimen, and measures of dyslipidemia, including serum TG and total, non-HDL, LDL, and HDL cholesterol

Source: https://euclinicaltrials.eu/ctis-public/view/2025-521521-33-00